EU clinical trial 2022-500762-10-00: Pulse Glucocorticoid Therapy In Patients With ST-Segment Elevation Myocardial Infarction (PULSE-MI)
Sponsor: Rigshospitalet (Hospital/Clinic/Other health care facility). Phase: Therapeutic exploratory (Phase II). Countries: Denmark (ended).
Therapeutic area(s): Diseases [C] - Cardiovascular Diseases [C14]
Gender: Female, Male. Age: 18-64 years, 65+ years. Enrolment: 742.
Start date (EU): 2022-11-14. Decision date: 2022-07-08. Results received: Yes. Last updated: 2023-04-14.

Condition(s): ST-segment myocardial infarction
Product: SOLU-MEDROL, Natriumklorid Fresenius Kabi 9 mg/ml infusionsvätska, lösning

Primary endpoint: Final infarct size (% of left ventricle mass) measured on late gadolinium enhancement (LGE) on cardiac magnetic resonance (CMR) 3 months following index event.
Endpoint(s): The extent of microvascular obstruction (MVO) on cardiac magnetic resonance (CMR), The extent of hemorrhage on cardiac magnetic resonance (CMR), Other cardiac magnetic resonance (CMR) efficacy parameters as specified in appendix A, All-cause mortality and hospitalization for heart failure at 3 months, Peak Troponin-T and creatine kinase myocardial band (CKMB), Safety: Incidence of adverse events the first seven days of the index event

Source: https://euclinicaltrials.eu/ctis-public/view/2022-500762-10-00